EU clinical trial 2023-506085-31-00: Pharmacokinetics of Nicorandil 40 mg Extended-Release Capsules: A Single-Dose, Open-Label, Randomized, Two-Sequence, Two-Treatment, Two-Period Crossover Study in Healthy Subjects Under Fasting and Fed Conditions.
Protocol code: AUX-PNI19-PK01
Sponsor: Auxilius Pharma Sp. z o.o. (Pharmaceutical company). Phase: Human Pharmacology (Phase I)- Other. Countries: Portugal (ended).
Therapeutic area(s): Not possible to specify
Gender: Female, Male. Age: 18-64 years. Enrolment: 16.
Status: Ended. Start date (EU): 2023-11-27. End date (EU): 2023-12-20. Decision date: 2023-11-03. Results received: Yes. Last updated: 2023-11-03.

Condition(s): No medical condition.
Product: Nicorandil

Primary endpoint: Cmax, AUC0-t , AUC0-∞, Tmax, Tlag, λz, t1/2, CL/F, Vz/F, MRCmax and MRAUC0-t of nicorandil and N-(2-hydroxyethyl) nicotinamide will be the primary pharmacocinetic parameters.
Endpoint(s): Occurrence of treatment-emergent adverse events (TEAEs). All vital signs, pulse oximetry, ECG, and laboratory tests results will be reported.

Source: https://euclinicaltrials.eu/ctis-public/view/2023-506085-31-00